EU clinical trial 2023-510128-66-00: A Phase 3 Study of Pembrolizumab in Combination With Carboplatin/Taxane (Paclitaxel or Nab-paclitaxel) followed by Pembrolizumab With or Without Maintenance MK-2870 in the First-line Treatment of Metastatic Squamous Non-small Cell Lung Cancer
Protocol code: MK-2870-023
Sponsor: Merck Sharp & Dohme LLC (Pharmaceutical company). Phase: Therapeutic confirmatory (Phase III). Countries: Italy (ongoing, recruiting), Czechia (ongoing, recruiting), Ireland (ongoing, recruiting), Germany (ongoing, recruiting), France (ongoing, recruiting), Spain (ongoing, recruiting), Austria (ongoing, recruiting), Poland (ongoing, recruiting), Hungary (ongoing, recruiting), Romania (ongoing, recruiting).
Therapeutic area(s): Diseases [C] - Neoplasms [C04]
Gender: Female, Male. Age: 18-64 years, 65+ years. Enrolment: 291.
Status: Ongoing, recruiting. Start date (EU): 2024-09-02. Decision date: 2024-08-12. Results received: No. Last updated: 2026-08-03.
Decision dates by country: IE: 2024-08-16, HU: 2024-08-16, AT: 2024-08-19, PL: 2024-08-13, IT: 2024-08-14, RO: 2024-08-19, FR: 2024-11-13, ES: 2024-08-12, DE: 2024-08-16, CZ: 2024-08-14

Condition(s): Participants with treatment-naïve metastatic squamous Non-small Cell Lung Cancer (NSCLC)
Product: MK-2870, DEXAMETHASONE, PACLITAXEL ALBUMIN-BOUND, MK-2870, KEYTRUDA 25 mg/mL concentrate for solution for infusion, PACLITAXEL, PARACETAMOL, CARBOPLATIN

Primary endpoint: Overall survival (OS)
Endpoint(s): Progression-Free Survival (PFS), Number of Participants With One or More Adverse Events (AEs), Number of Participants Discontinuing from Study Therapy Due to AE(s), Change in Score from Baseline to a Predefined Timepoint in Participant-Reported Global health status/Quality of Life (QoL) Score (EORTC QLQ-C30 Items 29 and 30), Change in Score from Baseline to a Predefined Timepoint in Participant-Reported Dyspnea (EORTC QLQ-C30 Item 8), Change in Score from Baseline to a Predefined Timepoint in Participant-Reported Cough (EORTC QLQ-LC13 Item 31), Change in Score from Baseline to a Predefined Timepoint in Participant-Reported Chest Pain (EORTC QLQ-LC13 Item 40), Time to First Deterioration (TTD) in Global Health Status/QoL Scores (EORTC QLQ-C30 Items 29 and 30), TTD in Dyspnea Score (EORTC QLQ-C30 Item 8), TTD in Cough Score (EORTC QLQ-LC13 Item 31), TTD in Chest Pain Score (EORTC QLQ-LC13 Item 40)

Source: https://euclinicaltrials.eu/ctis-public/view/2023-510128-66-00